EU clinical trial 2024-513393-22-00: Effect of Renal Impairment on Enpatoran Pharmacokinetics
Protocol code: MS200569_0051
Sponsor: Merck Healthcare KGaA (Pharmaceutical company). Phase: Human Pharmacology (Phase I)- Other. Countries: Germany (ended).
Therapeutic area(s): Diseases [C] - Immune System Diseases [C20]
Gender: Female, Male. Age: 18-64 years, 65+ years. Enrolment: 40.
Status: Ended. Start date (EU): 2024-09-04. End date (EU): 2026-04-13. Decision date: 2024-08-06. Results received: No. Last updated: 2026-03-23.

Condition(s): Healthy volunteers and patients with renal impairment; Intended indication: autoimmune diseases; systemic lupus erythematosus (SLE) and cutaneous lupus erythematosus (CLE), as well as dermatomyositis (DM) and polymyositis (PM).

Source: https://euclinicaltrials.eu/ctis-public/view/2024-513393-22-00